EU clinical trial 2024-515883-30-00: COMPARE STEMI ONE- Comparison Of reduced DAPT followed by P2Y12 inhibitor Monotherapy with Prasugrel vs tAndard Regimen in STEMI patients treated with OCT-guided vs aNgio-guided completE revascularization.
Protocol code: RM21
Sponsor: Research Maatschap Cardiologen Rotterdam Zuid (Laboratory/Research/Testing facility). Phase: Therapeutic use (Phase IV). Countries: Germany (ongoing, recruiting), Netherlands (ongoing, recruiting), Italy (ongoing, recruiting), Belgium (ongoing, recruiting), Czechia (ongoing, recruiting).
Therapeutic area(s): Diseases [C] - Cardiovascular Diseases [C14]
Gender: Female, Male. Age: 18-64 years, 65+ years. Enrolment: 1600.
Status: Ongoing, recruiting. Start date (EU): 2024-08-01. Decision date: 2024-07-20. Results received: No. Last updated: 2026-08-06.
Decision dates by country: BE: 2025-02-14, DE: 2024-07-25, IT: 2024-07-29, NL: 2024-07-20, CZ: 2025-03-11

Condition(s): St-Elevated Myocardial Infartion
Product: ACETYLSALICYLIC ACID, PRASUGREL

Primary endpoint: - Net Adverse Clinical Events (NACE) Composite endpoint of cardiovascular deaths, myocardial infarction, stroke or bleeding BARC 3 or 5 at 11 months post DAPT randomization., - Post-procedural Minimal Stent Area (MSA) Final Post-PCI MSA assessed by OCT in each randomized arm, measured at an independent OCT core laboratory blinded to imaging modality assignment.
Endpoint(s): Major Adverse Cerebrovascular Events (MACE) Composite endpoint of deaths, myocardial infarction or stroke at 2, 11 and 35 months, BARC type 3 or 5 at 2,11 and 35 months, Incidence of target vessel failure (TVF), the composite time-to-first event rate of death, target vessel myocardial infarction (TV-MI) (per-protocol MI definition), or ischemia-driven target vessel revascularization (ID-TVR) at 2, 11 and 35 months, Procedural outcomes OCT-defined (OCT core laboratory assessed). Subjects in the angiography-guided arm will undergo a post-PCI OCT run. Assessed per target lesion. 1. Stent expansion; 2. Mean stent expansion; 3. Edge dissection; 4.Stent Malapposition; 5.Border detection; 6.Untreated reference segmet disease, - Incidence of stent thrombosis (definite or probable as defined by the Academic Research Consortium

Source: https://euclinicaltrials.eu/ctis-public/view/2024-515883-30-00